EU clinical trial 2023-508171-36-00: A Study to Learn How Different Amounts of the Study Medicine Called PF-07293893 are Tolerated and Act in the Body of Healthy Adults.
Protocol code: C5171002
Sponsor: Pfizer Inc. (Pharmaceutical company). Phase: Human Pharmacology (Phase I)- Other. Countries: Belgium (ended).
Therapeutic area(s): Diseases [C] - Cardiovascular Diseases [C14]
Gender: Female, Male. Age: 18-64 years, 65+ years. Enrolment: 48.
Status: Ended. Start date (EU): 2023-12-15. End date (EU): 2024-08-27. End date: 2024-12-02. Decision date: 2023-12-13. Results received: No. Last updated: 2024-06-18.

Condition(s): heart failure with preserved ejection fraction

Source: https://euclinicaltrials.eu/ctis-public/view/2023-508171-36-00